EU clinical trial 2023-505975-54-00: A Phase III, Non-Inferiority, Randomized, Open-Label, Parallel Group, Multicenter Study to Investigate the Pharmacokinetics, Pharmacodynamics, Safety and Radiological and Clinical Effects of Subcutaneous Ocrelizumab Versus Intravenous Ocrelizumab in Patients with Multiple Sclerosis
Protocol code: CN42097
Sponsor: F. Hoffmann-La Roche AG (Pharmaceutical company). Phase: Therapeutic confirmatory (Phase III). Countries: Spain (ended), Czechia (ended), Poland (ended), Italy (ended).
Therapeutic area(s): Diseases [C] - Immune System Diseases [C20]; Diseases [C] - Nervous System Diseases [C10]
Gender: Female, Male. Age: 18-64 years. Enrolment: 153.
Status: Ended. Start date (EU): 2022-03-28. End date (EU): 2025-06-06. End date: 2025-06-07. Decision date: 2024-06-10. Results received: Yes. Last updated: 2025-04-01.
Decision dates by country: ES: 2024-06-10, PL: 2024-06-21, CZ: 2024-06-13, IT: 2024-06-19

Condition(s): Multiple Sclerosis (MS)
Product: Ocrevus, Ocrevus 300 mg concentrate for solution for infusion

Primary endpoint: 1. Serum ocrelizumab area under the concentration-time curve (AUC[w1-12]) after SC administration compared to IV infusion from Day 1 to Week 12
Endpoint(s): 1. Maximum serum concentration (Cmax) of ocrelizumab SC in patients with MS, 2. Total number of T1Gd+ lesions as detected by brain magnetic resonance imaging (MRI) at Weeks 8 and 24, 3. Total number of new or enlarging T2 lesions as detected by brain MRI at Weeks 12 and 24 relative to the previous scan, 4. Incidence and severity of adverse events, with severity determined according to the national cancer institute common terminology criteria for adverse events (NCI-CTCAE) version 5.0, 5. Change from baseline in targeted vital signs, 6. Change from baseline in targeted clinical laboratory test results, 7. Incidence of treatment-emergent antidrug antibodies (ADAs) to ocrelizumab after SC or IV administration relative to the presence of ADAs at baseline, 8. Relationship between ADA status to ocrelizumab and pharmacokinetics, pharmacodynamics, and safety, 9. Incidence of treatment-emergent antibodies to rHuPH20 after SC administration relative to the presence at baseline, 10. Relationships between antibodies to rHuPH20 and safety, 11. Percentage of patients achieving CD19+ B cell level <5 cells/microliter at Weeks 12, 24, 48, and/or 96, 12. Levels of biomarkers including but not limited to neurofilament light (NfL) in serum compared between dosing arms at Weeks 12, 24, 48 and/or 96 compared to baseline

Source: https://euclinicaltrials.eu/ctis-public/view/2023-505975-54-00